EU clinical trial 2022-502164-20-01: Semaglutide 2.4mg for low responders after bariatric surgery
Protocol code: NOK0024 / Z2023097
Sponsor: Stichting Zuyderland Medisch Centrum (Hospital/Clinic/Other health care facility). Phase: Therapeutic use (Phase IV). Countries: Netherlands (ongoing, recruiting).
Therapeutic area(s): Diseases [C] - Hormonal diseases [C19]; Analytical, Diagnostic and Therapeutic Techniques and Equipment [E] - Therapeutics [E02]; Health Care [N] - Environment and Public Health [N06]
Gender: Female, Male. Age: 18-64 years, 65+ years. Enrolment: 152.
Status: Ongoing, recruiting. Start date (EU): 2025-03-11. Decision date: 2024-09-04. Results received: No. Last updated: 2025-03-06.

Condition(s): obesity
Product: Semaglutide B 3.0 mg/ml PDS290

Primary endpoint: The main endpoint is change in %TWL from 3 to 18 months after bariatric surgery (15 months/ 68 weeks after semaglutide start). Assessment of bodyweight is standard part of treatment.
Endpoint(s): The secondary endpoints are %TWL at 3, 6, 12 and 18 months, metabolic health, quality of life and gastro-intestinal symptoms, cardiorespiratory fitness, liver fat and liver stiffness, and persistence of therapy (see attachment 1)., Body weight and BMI will be measured before surgery and 3, 6, 12 and 18 months after surgery. %TWL at 3, 6, 12 and 18 months after surgery will be calculated using the weight at start of treatment. Furthermore, waist circumference and waist/hip ratio will be measured at start of the treatment and at all follow up moments., Metabolic health will be defined by using the following parameters: blood pressure, HbA1c, glucose, triglycerides and LDL, HDL and total cholesterol. Hypertension and dyslipidemia will be recorded at all follow-up moments to assess whether there is improvement or remission of comorbid conditions in patients who have those comorbid conditions., Gastro-intestinal symptoms and eating habits of the patients will be assessed in two ways, first by adverse event rapportage and second with the “eating habits and physical problems” scales of the BODY-Q questionnaire. This same questionnaire will also be used to study HRQoL (see attachment 2). Before surgery and at 3 (start of study), 6, 12 and 18 months the HRQoL and gastro-intestinal symptoms will be assessed., Cardiorespiratory Fitness will be assessed before surgery, and at 3 (start of study), 6, 12 and 18 months after surgery. During the Åstrand test, participants cycle for 6 min on a cycle ergometer on submaximal level. After the test, VO2max is calculated by combining the patient’s characteristics (age, sex, weight, and fat-free mass (FFM)) with outcomes of the Åstrand test (level of resistance and heart rate)., Liver fat and liver stiffness will be assessed at the start of the study and after using semaglutide for 68 weeks. Using vibration controlled transient elastography this parameter will be assessed. Vibration controlled transient elastography (VCTE) is a diagnostically accurate method to assess liver fat and liver stiffness. All values will be expressed in kPa., For this we will assess: - Number and percentage of patients in whom dose escalation was according to protocol - Number and percentage of patients who used 2.4 mg as a weekly dose for 52 weeks - Average weekly dose of all patients (after the dose escalation)

Source: https://euclinicaltrials.eu/ctis-public/view/2022-502164-20-01